EU clinical trial 2024-512716-21-00: A Multicenter, Randomized, Double-Blind, Placebo-Controlled, Phase 3 Study to Evaluate the Efficacy and Safety of Telitacicept Compared to Placebo in Patients with Moderately to Severely Active Systemic Lupus Erythematosus (REMESLE-2)
Protocol code: RC18G002
Sponsor: Remegen Co. Ltd. (Pharmaceutical company). Phase: Therapeutic confirmatory (Phase III). Countries: Poland (not authorised), Greece (not authorised), Italy (not authorised), Romania (not authorised), Croatia (not authorised), France (not authorised).
Therapeutic area(s): Diseases [C] - Immune System Diseases [C20]
Gender: Female, Male. Age: 0-17 years, 18-64 years, 65+ years. Enrolment: 63.
Status: Not authorised. Decision date: 2025-01-17. Results received: No. Last updated: 2025-01-21.
Decision dates by country: HR: 2025-01-21, FR: 2025-01-17, GR: 2025-01-21, RO: 2025-01-21, PL: 2025-01-21, IT: 2025-01-20

Condition(s): Moderately to Severely Active Systemic Lupus Erythematosus
Product: Telitacicept injection, Matching placebo for Telitacicept

Primary endpoint: The proportion of patients achieving an SLE Responder Index (SRI-4) response at Week 52.
Endpoint(s): The proportion of patients achieving an SRI-4 response at Week 24., Among patients who were on an average daily dose of >7.5 mg/day prednisone or equivalent at baseline, the proportion of those patients achieving a GC dose reduction of ≥25% from baseline to ≤7.5 mg/day prednisone or equivalent by Week 40 and maintaining that dose through Week 52., The proportion of patients achieving an SRI-4 response at Week 52, while maintaining an average daily dose of ≤7.5 prednisone or equivalent between Week 40 and Week 52., The proportion of patients achieving a BILAG-based Combined Lupus Assessment (BICLA) response at Week 52., Time to flare assessed by SFI from baseline through Week 52., The proportion of patients achieving clinically meaningful improvement in the FACIT-F at Week 52., o Incidence of AE, SAEs, and AESI. o AEs that lead to patient discontinuation of study medication. o Change from baseline in vital sign parameters by visit. o Change from baseline in clinical laboratory assessments by visit.

Source: https://euclinicaltrials.eu/ctis-public/view/2024-512716-21-00